EU clinical trial 2025-523791-24-00: A study investigating the effect of curcumin on the absorption and elimination of IMU 838, a new compound that may potentially be used in the treatment of multiple sclerosis, and the effect of IMU 838 on the absorption and elimination of rosuvastatin.
Protocol code: P1-IMU-838-DDI-BCRP
Sponsor: Immunic AG (Pharmaceutical company). Phase: Human Pharmacology (Phase I)- Other. Countries: Netherlands (ended).
Therapeutic area(s): Diseases [C] - Nervous System Diseases [C10]
Gender: Female, Male. Age: 18-64 years. Enrolment: 28.
Status: Ended. Start date (EU): 2026-01-08. End date (EU): 2026-04-08. Decision date: 2025-12-17. Results received: No. Last updated: 2026-04-13.

Condition(s): Multiple sclerosis

Source: https://euclinicaltrials.eu/ctis-public/view/2025-523791-24-00